EU clinical trial 2025-524213-84-00: TAILORswitch (PADA-2): rising ctDNA to tailor endocrine therapy switch in patients with ER+/HER2- metastatic breast cancer
Protocol code: UC-BCG-2520
Sponsor: Unicancer (Hospital/Clinic/Other health care facility). Phase: Therapeutic confirmatory (Phase III). Countries: France (authorised, recruitment pending).
Therapeutic area(s): Diseases [C] - Neoplasms [C04]
Gender: Female, Male. Age: 18-64 years, 65+ years. Enrolment: 526.
Status: Authorised, recruitment pending. Decision date: 2026-07-06. Results received: No. Last updated: 2026-07-07.

Condition(s): Patients with advanced or metastatic ER+ HER2- breast cancer
Product: ABEMACICLIB, ABEMACICLIB, Camizestrant, ABEMACICLIB

Primary endpoint: Progression-free survival (PFS), defined as the time from randomization in step #2 until the date of objective disease progression per RECIST 1.1 as assessed by local investigator or death due to any cause, whichever occurs first. Participants without events will be censored at their date of last assessment. (Step 2)
Endpoint(s): Number of imaging assessments received per participant and per year Percentage of participants who followed the planned schedule of no more than one imaging assessment per year among participants enrolled in arm B., Rates of randomized participants in Step #1 (arm A & B) who experience a disease progression: - with no ctDNA detected prior to disease progression, - - - with visceral assessment), crisis (per investigator with altered general condition (ECOG PS ≥2), treated with chemotherapy as 2nd line of treatment, reported by randomization arm. Rates of randomized participants in Step #1 (arm A & B) - experiencing a venous thrombo-embolic event, adherent to the allocated imaging schedule, PFS (as defined in the primary endpoint) ; PFS2, (time to second tumor progression), defined as the time from randomization to the earliest progression after the 1st progression, or death from any cause; Time to chemotherapy, defined as the time from randomization until the start date of the 1st subsequent chemotherapy treatment after discontinuation treatment; of randomized OS, defined as the time from randomization to death from any cause., PFS, PFS2, Time to chemotherapy and OS, as defined above, reported in the per protocol population, Rate of AEs (per CTCAE v5.0) and SAEs, reported by treatment arm in Step #2 (arm C & D), Change from baseline in Quality of life, measured by EORTC QLQ-C30 and EORTC BR42 questionnaires

Source: https://euclinicaltrials.eu/ctis-public/view/2025-524213-84-00